EU clinical trial 2024-519496-26-00: A Phase 2b/3 Randomized Open-Label Dose-Selection Study with Open-Label Extension and Randomized Double-Blind, Placebo-Controlled Study with Open-Label Extension to Evaluate the Safety and Efficacy of Choline Chloride for Injection (Low Dose and High Dose) Versus Placebo in Adolescents and Adults with Intestinal Failure Receiving Long-Term Parenteral Support
Protocol code: TARA-001-301
Sponsor: Protara Therapeutics Inc. (Pharmaceutical company). Phase: Phase II and Phase III (Integrated). Countries: France (ongoing, recruiting), Denmark (ongoing, recruiting), Germany (ongoing, recruiting), Belgium (ongoing, recruiting), Poland (ongoing, recruiting).
Therapeutic area(s): Diseases [C] - Nutritional and Metabolic Diseases [C18]; Diseases [C] - Digestive System Diseases [C06]
Gender: Female, Male. Age: 0-17 years, 18-64 years, 65+ years. Enrolment: 117.
Status: Ongoing, recruiting. Start date (EU): 2025-09-25. Decision date: 2025-07-21. Results received: No. Last updated: 2026-03-09.
Decision dates by country: FR: 2025-07-25, DK: 2025-07-21, DE: 2025-07-25, PL: 2025-07-28, BE: 2025-07-23

Condition(s): Intestinal Failure
Product: Placebo to match Choline Chloride for Injection, Choline Chloride for Injection

Primary endpoint: Dose-Selection (DS) 1. Non-compartmental plasma free choline PK parameters during Week 1 and Week 8 Visits, and changes in PK parameters from Baseline to Week 8, Dose-Selection (DS) 2. Change from Baseline in time-matched plasma free choline concentrations at Week 8, Dose-Selection (DS) 3. Safety: Incidence and severity of TEAEs; Incidence of TESAEs, Double-Blind (DB) 1. Change from Baseline in peak plasma free choline concentrations at Week 8 in participants receiving Choline Chloride for Injection versus Placebo, Double-Blind (DB) 2. Safety: Incidence and severity of TEAEs; Incidence of TESAEs, Open-Label (OL) 1. Percentage of participants with plasma free choline concentrations of ≥ 9.5 nmol/mL at Week 64 ; Percentage of participants maintaining plasma free choline concentrations of ≥ 9.5 nmol/mL at Week 8 (, Week 24 depending on cohort) and Week 64, Open-Label (OL) 2. Safety: Incidence and severity of TEAEs; Incidence of TESAEs
Endpoint(s): Dose-Selection (DS) 1. Change from Baseline to Week 8 in ALP, AST, ALT, GGT, VLDL, total bilirubin, and direct bilirubin levels; Change from Baseline to Week 8 in CPK levels; Change from Baseline to Week 8 in homocysteine and albumin levels, Dose-Selection (DS) 2. Triplicate QTc measurements collected during Week 1 and Week 8, and changes from pre-infusion QTc at Week 1 to all post-baseline timepoints, Dose-Selection (DS) 3. Percentage of participants achieving plasma free choline concentration Cmax ≥ 9.5 nmol/mL at Week 8, Dose-Selection (DS) 4. Percentage of participants maintaining plasma free choline concentration Cmax ≥ 9.5 nmol/mL at Week 8, Dose-Selection (DS) 5. Change from Baseline to Week 8 in height, weight, and BMI, Dose-Selection (DS) 6. Percentage of participants with no worsening of steatosis from Baseline to Week 8 as measured by MRI-PDFF; Percentage of participants with any improvement of steatosis from Baseline to Week 8 as measured by MRI-PDFF, Double-Blind (DB) 1. Change from Baseline and Week 8 in peak plasma free choline concentrations at Week 24 in participants receiving Choline Chloride for Injection versus Placebo, Double-Blind (DB) 2. Percentage of participants achieving plasma free choline concentration Cmax ≥ 9.5 nmol/mL at Week 8, Double-Blind (DB) 3. Percentage of participants maintaining plasma free choline concentration Cmax ≥ 9.5 nmol/mL at Week 8 and Week 24 (ie, through Week 24), Double-Blind (DB) 4. Change from Baseline to Week 8 and Week 24 in height, weight, and BMI, Double-Blind (DB) 5. Change from Baseline to Week 8 and Week 24 in ALP, AST, ALT, GGT, VLDL, total bilirubin, and direct bilirubin levels; Change from Baseline to Week 8 and Week 24 in CPK levels ; Change from Baseline to Week 8 and Week 24 in homocysteine and albumin levels, Double-Blind (DB) 6a. Percentage of participants with no worsening of steatosis from Baseline to Week 24 as measured by MRI-PDFF; Percentage of participants with any improvement of steatosis from Baseline on MRI-PDFF at Week 24; Percentage of participants with no worsening in fibrosis grade from Baseline to Week 24, as measured by MRE and ELF test, Double-Blind (DB) 6b. Percentage of participants with improvement in fibrosis grade from Baseline to Week 24, as measured by MRE and ELF test; Percentage of participants with improvement of steatosis from Baseline on MRI-PDFF with improvement of ALP from Baseline to Week 24; Percentage of participants with improvement of steatosis from Baseline on MRI-PDFF with improvement of ALT or AST from Baseline to Week 24, Double-Blind (DB) 7. Assessment of Quality of Life based on CLDQ at Baseline and Week 24; Assessment of Quality of Life based on PGIS at Baseline and PGIC at Week 24, Open-Label (OL) 1. Change from Baseline (Week 1 for Dose-Selection Phase) (Week 1 or Week 24 for Double-Blind Phase) to Week 64 in ALP, AST, ALT, GGT, VLDL, total bilirubin, and direct bilirubin levels; Change from Baseline (Week 1 for Dose-Selection Phase) (Week 1 or Week 24 for Double-Blind Phase) to Week 64 in CPK levels; Change from Baseline (Week 1 for Dose-Selection Phase) (Week 1 or Week 24 for Double-Blind Phase) to Week 64 in in homocysteine and albumin levels, Open-Label (OL) 2. Change from Baseline (Week 1 for Dose-Selection Phase) (Week 1 or 24 for Double-Blind Phase) to Week 64 in height, weight and BMI, Open-Label (OL) 3a. Percentage of participants with no worsening of steatosis as measured by MRI-PDFF from Baseline (Week 1 for Dose-Selection Phase) (Week 1 or 24 for Double-Blind Phase) to Week 64; Percentage of participants with improvement of steatosis as measured by MRI-PDFF from Baseline (Week 1 for Dose-Selection Phase) (Week1 or 24 for Double-Blind Phase) to Week 64;, Open-Label (OL) 3b. Percentage of participants with no worsening in fibrosis grade as measured by MRE and ELF test from Baseline (Week 1 or 24 for Double-Blind Phase) to Week 64; Percentage of participants with improvement in fibrosis grade as measured by MRE and ELF test from Baseline (Week 1 or 24 for Double-Blind Phase) to Week 64, Open-Label (OL) 4. Assessment of Quality of Life based on CLDQ at Week 64 for Double-Blind Phase; Assessment of Quality of Life based on PGIC at Week 64 for Double-Blind Phase

Source: https://euclinicaltrials.eu/ctis-public/view/2024-519496-26-00